EU clinical trial 2025-522046-42-00: A Phase 3, multicentre, randomised (1:1), parallel-group, active-controlled, central reader colonoscopist-blind study to evaluate the bowel cleansing efficacy, safety, tolerability, palatability, and acceptability of PLENVU® as compared to sodium picosulfate in paediatric participants from 1 to < 18 years of age in preparation for colonoscopy (CLARITY)
Protocol code: NER1006-01/2025
Sponsor: Norgine Limited (Pharmaceutical company). Phase: Therapeutic confirmatory (Phase III). Countries: Poland (ongoing, recruiting), Netherlands (ongoing, recruiting), Hungary (ongoing, recruiting), Spain (ongoing, recruiting), Italy (ongoing, recruiting), Belgium (ongoing, recruiting), Germany (ongoing, recruiting), Croatia (authorised, recruitment pending), Portugal (authorised, recruitment pending).
Therapeutic area(s): Diseases [C] - Digestive System Diseases [C06]
Gender: Female, Male. Age: 0-17 years. Enrolment: 249.
Start date (EU): 2026-03-24. Decision date: 2025-12-22. Results received: No. Last updated: 2026-08-03.
Decision dates by country: BE: 2026-01-06, HU: 2026-01-07, NL: 2025-12-23, DE: 2026-02-06, ES: 2026-01-12, HR: 2026-07-17, PL: 2026-01-04, PT: 2026-05-21, IT: 2026-01-16

Condition(s): Colonic disease
Product: PLENVU Pulver zur Herstellung einer Losung zum Einnehmen, SODIUM PICOSULFATE

Primary endpoint: Success rate of bowel cleansing (percentage of participants achieving adequate cleansing) based on BBPS.
Endpoint(s): Success rate of bowel cleansing (percentage of participants achieving successful cleansing) based on HCS., Participant compliance with treatment., Tolerability, palatability, and acceptability questionnaire using a Likert Scale.

Source: https://euclinicaltrials.eu/ctis-public/view/2025-522046-42-00